EU clinical trial 2023-507096-21-00: A Phase 3, Multicenter, Open-Label 156-Week Extension Study To Evaluate The Long-Term Safety And Tolerability Of Oral Atogepant For The Prevention Of Migraine In Participants With Chronic Or Episodic Migraine
Protocol code: 3101-312-002
Sponsor: AbbVie Deutschland GmbH & Co. KG (Pharmaceutical company). Phase: Therapeutic confirmatory (Phase III). Countries: Spain (ended), Denmark (ended), Germany (ended), Hungary (ended), France (ended), Netherlands (ended), Czechia (ended), Italy (ended), Poland (ended).
Therapeutic area(s): Diseases [C] - Nervous System Diseases [C10]
Gender: Female, Male. Age: 18-64 years, 65+ years. Enrolment: 382.
Status: Ended. Start date (EU): 2021-08-16. End date (EU): 2025-10-09. End date: 2025-10-20. Decision date: 2023-12-18. Results received: No. Last updated: 2025-07-18.
Decision dates by country: CZ: 2023-12-20, DK: 2023-12-18, FR: 2023-12-26, NL: 2023-12-21, HU: 2023-12-20, DE: 2023-12-20, PL: 2024-02-02, ES: 2023-12-18, IT: 2024-01-23

Condition(s): Chronic or Episodic Migraine (Migraine without aura, migraine with aura, or chronic migraine)
Product: Atogepant

Primary endpoint: Percentage of Participants with at Least 1 Treatment Emergent Adverse Event
Endpoint(s): Percentage of Participants with Clinically Significant Laboratory Values (Chemistry, Hematology, Urinalysis) as assessed by the Investigator, Percentage of Participants with Clinically Significant Electrocardiograms (ECGs) Findings as assessed by the Investigator, Percentage of Participants with Clinically Significant Vital Sign Measurements as assessed by the Investigator, Percentage of Participants with Clinically Significant Laboratory values, ECG findings or Vital Sign measures as assessed by Investigator; and results of the CSSRS Scale.

Source: https://euclinicaltrials.eu/ctis-public/view/2023-507096-21-00